EU clinical trial 2025-520492-10-00: Premedication for Less Invasive Surfactant Administration (LISA-Med)
Sponsor: Pohjois-Pohjanmaan hyvinvointialue, University Of Oulu (Hospital/Clinic/Other health care facility, Educational Institution). Phase: Therapeutic use (Phase IV). Countries: Finland (authorised, recruitment pending).
Therapeutic area(s): Analytical, Diagnostic and Therapeutic Techniques and Equipment [E] - Anesthesia and Analgesia [E03]
Gender: Female, Male. Age: 0-17 years. Enrolment: 40.
Status: Authorised, recruitment pending. Decision date: 2025-01-28. Results received: No. Last updated: 2025-01-28.

Condition(s): respiratory distress syndrome, surfactant treatment, premedication
Product: Fentanyl-hameln 50 Mikrogramm/ml Injektionslösung, Ketanest-S 5 mg/ml injektio-/infuusioneste, liuos

Primary endpoint: Any adverse event (the need of positive pressure ventilation, intubation, heart rate below 80/min, mean arterial pressure change more than 20%, pH change more than 0.4, CO2 change more than 20%, and saturation <85 for more than 1 minute)
Endpoint(s): Duration of the procedure, Number of attempts to get the catether intratracheally, Pain score NIAPAS, The need for additional dosing of study drug or midazolam (number of addtional dosages), Edi-signals

Source: https://euclinicaltrials.eu/ctis-public/view/2025-520492-10-00